EU clinical trial 2024-517741-14-00: A Phase I/IIa Study of Roginolisib in combination with dostarlimab with or without docetaxel in patients with advanced non-squamous NSCLC who have progressed on standard of care immune checkpoint therapy and platinum doublet chemotherapy or standard immunotherapy without chemotherapy (PULMO-01).
Protocol code: IOA-244-202
Sponsor: iOnctura SA (Pharmaceutical company). Phase: Phase I and Phase II (Integrated)- Other. Countries: Belgium (ongoing, recruitment ended), Spain (ongoing, recruitment ended), Italy (ongoing, recruitment ended).
Therapeutic area(s): Diseases [C] - Respiratory Tract Diseases [C08]
Gender: Female, Male. Age: 18-64 years, 65+ years. Enrolment: 51.
Status: Ongoing, recruitment ended. Start date (EU): 2025-04-22. Decision date: 2025-03-25. Results received: No. Last updated: 2026-08-04.
Decision dates by country: IT: 2025-03-27, BE: 2025-03-26, ES: 2025-03-25

Condition(s): advanced non-squamous non-small cell lung cancer (NSCLC)
Product: Docetaxel 20 mg/ml concentrate for solution for infusion, IOA-244, JEMPERLI 500 mg concentrate for solution for infusion

Primary endpoint: Change from baseline of at least 50% by Day 42 as assessed by mass cytometry (cytometry by time of flight, CyTOF).
Endpoint(s): AEs (graded by Common Terminology Criteria for Adverse Event [CTCAE] version 5.0), serum chemistry and haematology laboratory examinations, physical examinations., Change from baseline in immune related signatures as assessed by mass cytometry., Objective response rate (ORR), duration of response (DOR), Disease Control Rate (DCR), Clinical Benefit Rate (CBR) and progression free survival (PFS) per RECIST v1.1 as assessed by the investigator and overall survival (OS)., Plasma concentrations of roginolisib., AEs (graded by CTCAE version 5.0), serum chemistry and haematology laboratory examinations, physical examinations.

Source: https://euclinicaltrials.eu/ctis-public/view/2024-517741-14-00